EU clinical trial 2024-511037-35-00: A phase II, multicenter, 1:1 randomized, double-blind, placebo-controlled, parallel-group study to evaluate the efficacy of bolus application of Cyclosporine A (CsA) or Placebo in patients with Takotsubo syndrome. (Cyclosporine In Takotsubo syndrome (CIT))
Protocol code: CIT
Sponsor: Universitaetsklinikum Heidelberg AöR (Hospital/Clinic/Other health care facility). Phase: Therapeutic exploratory (Phase II). Countries: Germany (ongoing, recruiting).
Therapeutic area(s): Diseases [C] - Cardiovascular Diseases [C14]
Gender: Female, Male. Age: 18-64 years, 65+ years. Enrolment: 204.
Status: Ongoing, recruiting. Start date (EU): 2025-01-31. Decision date: 2024-08-30. Results received: No. Last updated: 2026-07-30.

Condition(s): Cyclosporine A is a well known medication and is used to prevent rejection after solid organ transplantation and in the treatment of inflammatory disorders such as myocarditis.
Product: SODIUM CHLORIDE, Sandimmun® 50 mg/ml Konzentrat zur Herstellung einer Infusionslösung

Primary endpoint: Primary efficacy endpoint: Reduction of myocardial damage quantified by AUC of centrally measured highsensitive cardiac Troponin T (TnT) over 72 h.
Endpoint(s): Change in TnT/NTproBNP at T3/12/24/36/48/60/72/M1 and change in LVEF at T48/72/M1 (vs. baseline), Myocardial edema/inflammation at T48-72 (cMRI, T2 SIand EGE ratio (lake louise criteria)), Length of stay on IMC/ICU and length of hospital stay, Composite cardiovascular outcome at 30d and 1year: mortality from any cause, stroke, myocardial infarction, heart failure, hospitalization, recurrent TTS, cardiac arrest / ventricular fibrillation, ventricular tachycardia, novel atrial fibrillation, thromboembolism, LV-Thrombus, AV-Block, ventricular rupture and new onset atrial fibrillation, Psychosocial and quality of life assessments between groups at M1 vs. M12

Source: https://euclinicaltrials.eu/ctis-public/view/2024-511037-35-00